EU clinical trial 2025-521452-30-01: EUROpean pragmatic multicenter randomized trial on platelet inhibition and/or lipid lowering treatment in Covert Brain Infarction (CBI)
Sponsor: Region Midtjylland (Hospital/Clinic/Other health care facility). Phase: Therapeutic confirmatory (Phase III). Countries: Denmark (ongoing, recruiting), Sweden (authorised, recruitment pending).
Therapeutic area(s): Diseases [C] - Nervous System Diseases [C10]
Gender: Female, Male. Age: 18-64 years, 65+ years. Enrolment: 1252.
Start date (EU): 2025-11-18. Decision date: 2025-10-17. Results received: No. Last updated: 2026-07-22.
Decision dates by country: SE: 2026-07-22, DK: 2025-10-17

Condition(s): Covert brain infarction (asymptomatic brain infarctions)
Product: CLOPIDOGREL, ATORVASTATIN, ROSUVASTATIN, ACETYLSALICYLIC ACID

Primary endpoint: Primary efficacy endpoint: MACCE. Primary safety endpoint: Fatal or major bleeding.
Endpoint(s): Dementia (All-cause based on ICD-10 or ICD-11 diagnosis), Cardiovascular Mortality, Cognitive Decline (MoCA-score), Biomarkers of inflammation (Hs-CRP at baseline and correlated to the risk of future vascular events (MACCE), mortality (all-cause), and dementia (all-cause). ), The association between baseline physical activity levels, as measured by the International Physical Activity Questionnaire (IPAQ), and the incidence of MACCE at 36 months, mRS: The change in mRS score will be assessed from baseline to 12 and 36 months to evaluate shifts in functional independence and disability over time., Clinical frailty scale: The change in CFS score will be assessed from baseline to 12 and 36 months to evaluate the progression of frailty and its impact on functional status and overall health over time., Barthel Index (BI): The change in BI score will be assessed from baseline to 12 and 36 months to evaluate the progression of functional independence in daily activities and overall disability status over time., Quality of Life (EQ-5D): The change in EQ-5D score will be assessed from baseline to 12 and 36 months to evaluate variations in health-related quality of life over time., MRI markers: At baseline the MRI SVD score will be estimated, and the score will be compared to the risk of future vascular events (MACCE), mortality (all-cause), and dementia (all-cause)., Repeated MRI after 3 years: Newly developed lacunar and/or cortical infarctions will be recorded and a SVD score, Global Cortical Atrophy (GCA) Scale, Fazekas grade and number of cerebral microbleeds will be calculated, Ultrasonography (sub-study): The common- and internal carotid artery will be assessed for signs of atherosclerotic disease including plaques quantification.

Source: https://euclinicaltrials.eu/ctis-public/view/2025-521452-30-01